EU clinical trial 2024-517330-18-00: Efficacy and safety of trifluridin/tipiracil in combination with nanoliposomal irinotecan as a second line therapy in patients with cholangiocarcinoma
Protocol code: TRITICC-2
Sponsor: Heinrich-Heine-Universitaet Duesseldorf (Educational Institution). Phase: Therapeutic exploratory (Phase II). Countries: Germany (ongoing, recruiting).
Therapeutic area(s): Diseases [C] - Neoplasms [C04]; Diseases [C] - Digestive System Diseases [C06]
Gender: Female, Male. Age: 18-64 years, 65+ years. Enrolment: 38.
Status: Ongoing, recruiting. Start date (EU): 2025-10-02. Decision date: 2025-07-31. Results received: No. Last updated: 2025-11-10.

Condition(s): advanced, non resectable or metastatic cholangio- or gallbladder carcinoma after failure to respond to a previous gemcitabine treatment
Product: Lonsurf 20 mg/8.19 mg film-coated tablets, Onivyde pegylated liposomal 4.3 mg/ml concentrate for dispersion for infusion, Lonsurf 15 mg/6.14 mg film-coated tablets

Primary endpoint: Median progression free survival (PFS) assessed by the local investigator at each site (time from first administration of chemotherapy to the date of radiological or clinical tumor progression or death of any cause whichever comes first).
Endpoint(s): Progression-free survival rate at 4 months defined as the proportion of patients with non-progressive disease 4 months after inclusion by intention to treat analysis, Median overall survival (time interval from first administration of chemotherapy to date of death from any cause), Proportion of patients with an objective response according to RECIST 1.1, Type, frequency and severity of adverse events according to NCI CTCAE version 5.0 specifying seriousness and expectedness (AE, SAE, SUSAR), Health related QoL according to EORTC QLQ C30 and the EQ-5D-5L

Source: https://euclinicaltrials.eu/ctis-public/view/2024-517330-18-00